EU clinical trial 2024-512190-27-00: A Phase II, prospective, intra-patient randomised controlled, multicentre study to evaluate the safety and efficacy of an autologous bio-engineered dermo-epidermal skin substitute (EHSG-KF) for the treatment of full thickness skin defects in adults and children in comparison to autologous split-thickness skin grafts (STSG) (RAC)
Protocol code: TBRU-dS-RAC-PII
Sponsor: Cutiss AG (Pharmaceutical company). Phase: Therapeutic exploratory (Phase II). Countries: Italy (ended), Netherlands (ended).
Therapeutic area(s): Diseases [C] - Skin and Connective Tissue Diseases [C17]
Gender: Female, Male. Age: 0-17 years, 18-64 years, 65+ years. Enrolment: 15.
Status: Ended. Start date (EU): 2019-05-13. End date (EU): 2026-06-29. Decision date: 2024-10-28. Results received: No. Last updated: 2026-06-25.
Decision dates by country: IT: 2024-11-04, NL: 2024-10-28

Condition(s): Adults and children with full thickness skin defects
Product: EHSG-KF

Primary endpoint: Efficacy evaluation, as a comparison between the EHSG-KF and control sites, based on assessment of general scar quality at the study areas using the POSAS questionnaire, observer total score at: visit 8 (90 days ± 5 days post grafting)
Endpoint(s): Efficacy evaluation, as a comparison between the EHSG-KF and control sites, based on (1): • Scar quality at the study areas in comparison to control areas: o Cutometer® pliability parameter at visit 8 (90 days ± 5 days post grafting) as key secondary efficacy endpoint o Other Cutometer® parameters (extension, elasticity, retraction, viscoelasticity) at visit 8 (90 days ± 5 days post grafting), Based on (2): • Scar quality at the study areas in comparison to control areas: o POSAS questionnaire observer items (vascularity, pigmentation, thickness, relief, pliability) at visit 8 (90 days ± 5 days post grafting) o POSAS questionnaire patient items (pain, itching, colour, pliability, thickness, relief) and total score at visit 8 (90 days ± 5 days after grafting), Based on (3): • Scar quality at the study areas in comparison to control areas: DSM ColorMeter® (erythema and pigmentation) at: visit 10 (1 year ± 30 days post grafting) o Optional biopsies of the study area and control area at visit 10 (1 year ± 30 days after grafting) for histological assessment. (optional) o Graft take at Visit 4 (6-10 days after grafting) o % Epithelialization at Visit 6 (28 days ± 3 days after grafting), Secondary safety endpoints: • Clinical and microbiologic signs of infection at o visit 4 (6-10 days post grafting) o visit 5 (21 ± 2 days post grafting) • Adverse events o Assessment and reporting of all observed adverse events will be carried out for the full duration of the study from visit 2 on., Other secondary efficacy endpoint: • QOL assessment: visit 10 (1 year ± 30 days post grafting) o EQ-5D and BSHS-B for patients ≥18 years with reconstruction of burn scars o EQ-5D only for patients ≥18 years without burn scars o EQ-5DY and PedsQL for patients <18 years

Source: https://euclinicaltrials.eu/ctis-public/view/2024-512190-27-00